EU clinical trial 2022-502139-20-00: Semaglutide Treatment for Prevention of Toxicity in High-dose Chemotherapy with Autologous Hematopoietic Stem Cell Transplantation – a randomized, double-blind, placebo-controlled, investigator-initiated study
Protocol code: PROTECT
Sponsor: Rigshospitalet (Hospital/Clinic/Other health care facility). Phase: Therapeutic exploratory (Phase II). Countries: Denmark (ongoing, recruiting).
Therapeutic area(s): Diseases [C] - Digestive System Diseases [C06]
Gender: Female, Male. Age: 18-64 years, 65+ years. Enrolment: 40.
Status: Ongoing, recruiting. Start date (EU): 2024-09-09. Decision date: 2023-03-21. Results received: No. Last updated: 2025-06-18.

Condition(s): Mucositis and systemical inflammation, which is a treatment-related complication after treatment with high-dose chemotherapy
Product: Ozempic 0.25 mg solution for injection in pre-filled pen, Semaglutide placebo (saline), Pharmaceutical form: Solution for injection, Route of administration: Subcutaneous injection, 1.5 ml pre-filled pen-injector

Primary endpoint: GI mucositis severity: mean severity grade (0-II) from study week 5 to 9
Endpoint(s): CRP increment in the early post-transplant phase: area under the plasma concentration-time curve (AUC) from study week 5 to 8, Quality of life (QOL): change from baseline (study week 4) to study week 9 and 18 evaluated by EORTC QLQ-C30 and EORTC QLQ-HDC29 questionnaires, Safety profile: evaluated by SAR according to ICH-GCP guidelines

Source: https://euclinicaltrials.eu/ctis-public/view/2022-502139-20-00